EU clinical trial 2025-524194-17-00: EFFICACY OF PROPRANOLOL IN TRAUMATIC BRAIN INJURY PATIENTS ADMITTED TO THE ICU: A PROSPECTIVE, RANDOMIZED, TRIPLE-BLIND STUDY (ProP TBI in ICU)
Protocol code: Prop-TCE 04-2025
Sponsor: University Hospital Son Espases (Hospital/Clinic/Other health care facility). Phase: Therapeutic confirmatory (Phase III). Countries: Spain (authorised, recruitment pending).
Therapeutic area(s): Diseases [C] - Nervous System Diseases [C10]
Gender: Female, Male. Age: 18-64 years, 65+ years. Enrolment: 600.
Status: Authorised, recruitment pending. Decision date: 2026-02-05. Results received: No. Last updated: 2026-04-15.

Condition(s): Head injury
Product: METHYLCELLULOSE, Propranolol 10 mg Tablets

Primary endpoint: Hospital mortality
Endpoint(s): Glasgow outcome scale extended

Source: https://euclinicaltrials.eu/ctis-public/view/2025-524194-17-00